EU clinical trial 2024-513332-17-00: A Phase Ib/II first-in-human, multicentre, open-label, multiple ascending dose study to assess the safety, tolerability, pharmacokinetics, and pharmacodynamic effect of intrathecal S230815 in paediatric participants with KCNT1-related Developmental and Epileptic Encephalopathy
Protocol code: CL1-230815-001
Sponsor: Institut De Recherches Internationales Servier IRIS (Pharmaceutical company). Phase: Phase I and Phase II (Integrated)- First administration to humans. Countries: France (ongoing, recruiting), Italy (ongoing, recruiting), Spain (ongoing, recruiting).
Therapeutic area(s): Diseases [C] - Nervous System Diseases [C10]
Gender: Female, Male. Age: 0-17 years. Enrolment: 20.
Status: Ongoing, recruiting. Start date (EU): 2025-11-19. Decision date: 2025-08-04. Results received: No. Last updated: 2026-07-30.
Decision dates by country: FR: 2025-08-04, ES: 2025-10-02, IT: 2025-11-07

Condition(s): KCNT1-related Developmental and Epileptic Encephalopathy
Product: S230815 Solution for injection 10mg/ml

Primary endpoint: Incidence and severity of adverse events (AEs).
Endpoint(s): PK parameters of S230815 [CCI] Cmax, plasma Ctrough and plasma AUC0-τ [CCI]

Source: https://euclinicaltrials.eu/ctis-public/view/2024-513332-17-00